EU clinical trial 2024-514597-42-00: Combining anti-PD-L1 immune checkpoint inhibitor durvalumab with TLR-3 agonist rintatolimod in patients with metastatic pancreatic ductal adenocarcinoma for therapy efficacy. DURIPANC Study
Sponsor: Erasmus Universitair Medisch Centrum Rotterdam (Erasmus MC) (Hospital/Clinic/Other health care facility). Phase: Phase I and Phase II (Integrated)- Other. Countries: Netherlands (ongoing, recruitment ended).
Therapeutic area(s): Diseases [C] - Neoplasms [C04]; Diseases [C] - Digestive System Diseases [C06]
Gender: Female, Male. Age: 18-64 years, 65+ years. Enrolment: 43.
Status: Ongoing, recruitment ended. Start date (EU): 2024-01-16. Decision date: 2024-08-02. Results received: No. Last updated: 2026-06-18.

Condition(s): Metastatic pancreatic cancer
Product: Ampligen, IMFINZI 50 mg/mL concentrate for solution for infusion.

Primary endpoint: Phase Ib The primary endpoint of the safety run-in (phase Ib) is the recommended phase II dose (RP2D) defined by the highest dose per protocol without dose-limiting toxicity (DLT) according to a 3+3 design (see section 8.3.2 and 8.3.7) related to the intervention from the start of rintatolimod until 6 weeks after the first day of the first cycle of durvalumab (one cycle is 28 days)., Phase II The primary endpoint of the phase II trial is the clinical benefit rateclinical benefit rate; response is defined as stable disease, partial or complete response according to Response Evaluation Criteria in Solid Tumors (RECIST 1.1) determined 6 months after start of combination therapy.
Endpoint(s): Overall survival (OS), defined as the time between start combination therapy with durvalumab and rintatolimod to date of death., Progression free survival (PFS), defined as the time between start of combination therapy with durvalumab and rintatolimod to date of progression (according to RECIST criteria version 1.1) or death, whichever occurs first., Immunogenic efficacy defined as >50% increase in circulating Ki67+ CD 8+ T cell in the peripheral blood., Infiltrating immune profile defines as the change in infiltrating immune profile after start of combination therapy., Quality of life (EORTC QLQ-C30), measured at baseline, after 5 weeks, 13 weeks, 25 weeks, 37 weeks, and 49 weeks after start immunotherapy.

Source: https://euclinicaltrials.eu/ctis-public/view/2024-514597-42-00